EU clinical trial 2025-520499-24-00: A Phase 3, randomized, parallel-group, double-blind, multicenter study investigating the safety and efficacy of NT 201 compared with placebo in adult participants with moderate to severe platysma prominence in Europe
Protocol code: NT-PPR-EU002
Sponsor: Merz Aesthetics GmbH (Pharmaceutical company). Phase: Therapeutic confirmatory (Phase III). Countries: Germany (ongoing, recruitment ended), Poland (ongoing, recruitment ended), France (ongoing, recruitment ended), Spain (ongoing, recruitment ended).
Therapeutic area(s): Not possible to specify
Gender: Female, Male. Age: 18-64 years, 65+ years. Enrolment: 260.
Status: Ongoing, recruitment ended. Start date (EU): 2025-10-01. Decision date: 2025-09-12. Results received: No. Last updated: 2026-08-07.
Decision dates by country: PL: 2025-09-19, ES: 2025-09-15, FR: 2026-02-05, DE: 2025-09-16

Condition(s): Moderate to Severe Platysma Prominence
Product: Bocouture, Placebo excipients (sucrose and human serum albumin) are reconstituted with sterile saline. Placebo vials will have identical appearance as the active product vials.

Primary endpoint: Composite achievement of Grade 1 (‘none to minimal’) or Grade 2 (‘mild’) AND at least a 2-grade improvement from baseline based on both the investigator’s assessment and participant’s self-assessment using the MAPS-D at Visit 4 (V4; Main Period [MP] Week 2).
Endpoint(s): • Achievement of Grade 1 (‘none to minimal’) or Grade 2 (‘mild’) AND at least 2-grade improvement from baseline based on the investigator’s assessment using MAPS-D at V4., • Achievement of Grade 1 (‘none to minimal’) or Grade 2 (‘mild’) AND at least a 2-grade improvement from baseline based on the participant’s self-assessment using MAPS-D at V4., • Achievement of at least a +1 (‘somewhat satisfied’) score using the participant’s satisfaction questionnaire at V4.

Source: https://euclinicaltrials.eu/ctis-public/view/2025-520499-24-00